EU clinical trial 2023-510088-37-00: A randomized, open-label, multi-center, comparative trial, to assess the efficacy and safety of pritelivir for the treatment of acyclovir-resistant mucocutaneous HSV infections in immunocompromised subjects (PRIOH-1)
Protocol code: AIC316-03-II-01
Sponsor: AiCuris Anti-infective Cures AG (Pharmaceutical company). Phase: Therapeutic confirmatory (Phase III). Countries: France (ended), Belgium (ended), Germany (ended), Greece (ended), Italy (ended).
Therapeutic area(s): Diseases [C] - Virus Diseases [C02]
Gender: Female, Male. Age: 0-17 years, 18-64 years, 65+ years. Enrolment: 54.
Status: Ended. Start date (EU): 2022-03-15. End date (EU): 2025-10-30. End date: 2025-11-11. Decision date: 2024-06-14. Results received: No. Last updated: 2025-07-21.
Decision dates by country: GR: 2024-08-28, BE: 2024-06-17, IT: 2024-06-19, DE: 2024-06-18, FR: 2024-06-14

Condition(s): Acyclovir-resistant mucocutaneous HSV infections in immunocompromised subjects
Product: ANHYDROUS CIDOFOVIR, Foscavir 24 mg/ml Solution for Infusion, Pritelivir mesylate monohydrate, IMIQUIMOD

Primary endpoint: Cure rate: number of subjects cured (all lesions healed as assessed by the Investigator) during the treatment period of up to 28 days relative to the total number of subjects treated with trial medication in the respective treatment group.
Endpoint(s): (Part C) Cure rate: number of subjects cured (all lesions healed as assessed by the Investigator) during the treatment period of up to 42 days relative to the total number of subjects treated with trial medication in the respective treatment group., (Part C) Time to lesion healing, defined as complete epithelization of the mucocutaneous HSV lesion(s) within the treatment period and no appearance of new lesions, as assessed by the Investigator., (Part C) Recurrence rate at 1, 2, and 3 months following PoTV, defined as number of subjects with a recurrence as assessed by the Investigator following 1/2/3 months after PoTV relative to the total number of subjects assessed for recurrence, (Part C) Pain rate: number of days with pain at lesion site relative to the total number of days with analyzable pain data through daily subject selfreporting., (Part C) Time to pain cessation at site of lesion starting at first dose of trial medication until pain is no longer reported by the subject (date and time)., (Part C) Average pain score using a single-dimensional scale assessing pain intensity (NUMERIC RATING SCALE [NRS]), 11 intensities: no pain to worst pain imaginable) through daily subject self-reporting., (Part C) Clinical shedding rate (number of HSV positive HSV PCR swabs per subject relative to the total number of swabs collected per subject) from HSV PCR swabs taken from HSV lesion(s) until healing., (Part C) Time to cessation of shedding., (Part C) Mean log number of HSV DNA copies on HSV DNA positive HSV PCR swabs from lesion(s) as detected by quantitative real-time polymerase chain reaction (PCR)., (Part C) Resistance to trial medication for lesions not healed within the treatment period or newly appeared lesions under treatment before or at the PoTV. Only applicable for trial medication comprising pritelivir, foscarnet, or cidofovir.

Source: https://euclinicaltrials.eu/ctis-public/view/2023-510088-37-00